EU clinical trial 2024-515952-19-00: Multicenter, open label study using molecularly determined targeted therapies in children 3-18 years of age with DIPG (diffuse intrinsic pontine glioma- DIPG)- DIPGen
Protocol code: DIPGen
Sponsor: Instytut Pomnik Centrum Zdrowia Dziecka (Hospital/Clinic/Other health care facility). Phase: Therapeutic exploratory (Phase II). Countries: Poland (ongoing, recruiting).
Therapeutic area(s): Diseases [C] - Neoplasms [C04]
Gender: Female, Male. Age: 0-17 years, 18-64 years. Enrolment: 100.
Status: Ongoing, recruiting. Start date (EU): 2024-12-18. Decision date: 2024-12-18. Results received: No. Last updated: 2025-04-25.

Condition(s): diffuse intrinsic pontine glioma
Product: Rapamune 1 mg/mL oral solution, Mekinist 0.5 mg film-coated tablets, Rapamune 1 mg coated tablets

Primary endpoint: Overall survival (OS) from the time of diagnosis until last visit or death, Safety assessment of sirolimus administered during radiotherapy and in combination with trametinib as adjunctive treatment after irradiation
Endpoint(s): Progression free survival from diagnosis to progression, Response rate assessed at time points specified in the protocol (MRI every 2 months from commnecement of systemic treatment), Quality of life assessment (using PedQoL- pediatric quality of life inventory) at time points specified in the protocol, Comparison of safety in 2 groups of patients; treated with sirolimus alone or in combination with trametinib

Source: https://euclinicaltrials.eu/ctis-public/view/2024-515952-19-00